EU clinical trial 2024-515740-23-00: A Randomized, Double-Blind, Multicenter Phase 3 Trial of BMS-986489 (BMS-986012 + Nivolumab Fixed Dose Combination) in Combination with Carboplatin plus Etoposide vs Atezolizumab in Combination with Carboplatin plus Etoposide as First-line Therapy in Extensive-Stage Small Cell Lung Cancer
Protocol code: CA245-0001
Sponsor: Bristol-Myers Squibb Services Unlimited Company (Pharmaceutical company). Phase: Therapeutic confirmatory (Phase III). Countries: France (ongoing, recruitment ended), Romania (ongoing, recruitment ended), Netherlands (ongoing, recruitment ended), Greece (ongoing, recruitment ended), Spain (ongoing, recruitment ended), Austria (ongoing, recruitment ended), Poland (ongoing, recruitment ended), Belgium (ongoing, recruitment ended), Italy (ongoing, recruitment ended), Czechia (ongoing, recruitment ended), Germany (ongoing, recruiting).
Therapeutic area(s): Diseases [C] - Neoplasms [C04]
Gender: Female, Male. Age: 18-64 years, 65+ years. Enrolment: 212.
Start date (EU): 2025-03-25. Decision date: 2025-03-10. Results received: No. Last updated: 2026-03-18.
Decision dates by country: FR: 2025-03-10, RO: 2025-03-12, NL: 2025-03-11, BE: 2025-03-10, IT: 2025-04-16, ES: 2025-03-10, PL: 2025-03-16, CZ: 2025-03-12, DE: 2025-03-10, AT: 2025-03-10, GR: 2025-03-10

Condition(s): Extensive-Stage Small Cell Lung Cancer (ES-SCLC)
Product: ETOPOSIDE, Atigotatug + Nivolumab FDC, CARBOPLATIN, ATEZOLIZUMAB

Primary endpoint: Overall survival: how long participants live after entering the study (i.e. after randomization)
Endpoint(s): Time for disease related symptoms to get worse (TTDD)., Safety: side effects, the number of side effects, type, severity, seriousness, and outcome., Response: measurements to indicate how many patients' tumors shrink or disappear after treatment (Overall Response)., How long the tumors stay shrunk or disappear (Duration of Response), The time during and after treatment that a participant lives without their disease getting worse (Progression Free Survival).

Source: https://euclinicaltrials.eu/ctis-public/view/2024-515740-23-00